EU clinical trial 2024-516665-36-00: Phase 1/2, Open label & double-blind randomized placebo-controlled study to assess the feasibility of BGC101 (EnEPC) in the treatment of peripheral arterial disease (PAD) with critical limb ischemia (CLI)
Protocol code: EnEPC-CLI-01
Sponsor: Biogencell Ltd. (Hospital/Clinic/Other health care facility). Phase: Phase I and Phase II (Integrated)- First administration to humans. Countries: Belgium (ongoing, recruitment ended).
Therapeutic area(s): Diseases [C] - Cardiovascular Diseases [C14]
Gender: Female, Male. Age: 18-64 years, 65+ years. Enrolment: 5.
Status: Ongoing, recruitment ended. Start date (EU): 2024-01-23. Decision date: 2024-10-16. Results received: No. Last updated: 2024-10-16.

Condition(s): Peripherial arterial disease (PAD) & Chronic-Limb Threatening Ischemia (CLTI) patients who have not responded to standard pharmacological treatment or control of risk factors, and/or had a revascularisation with continued presence of smaller vessel (microvasculature) disease, and do not have the option of a revascularization treatment.
Product: X-vivo 15 (serum-free growth medium manufactured under gmp and commercially available from Lonza)

Primary endpoint: The primary safety endpoints will consist of: • Incidence and proportion of incidence between treatment arms of adverse events of specific interest (AESI) and injection-related AE • Incidence of serious adverse events (SAEs) including SAEs related or probably related to the treatment • Vital signs and physical examination • Safety laboratory values of hematology, blood chemistry, and urinalysis • Local tolerability (injection site reaction), The primary efficacy endpoints will consist of: • Major amputation (below or above the knee) rate at Month 12 • Major amputation-free survival (AFS) rate at Month 12

Source: https://euclinicaltrials.eu/ctis-public/view/2024-516665-36-00